EU clinical trial 2023-509648-88-00: Phase I/II, open-label, multi-center study to evaluate the safety and efficacy of glyco-humanized polyclonal antibody directed against tumoral T cells, in patients with relapsed/refractory peripheral T cells lymphoma (PTCL).
Protocol code: XT 23-10
Sponsor: Xenothera (Pharmaceutical company). Phase: Phase I and Phase II (Integrated)- Other. Countries: France (ongoing, recruiting), Italy (ongoing, recruiting).
Therapeutic area(s): Diseases [C] - Neoplasms [C04]; Diseases [C] - Hemic and Lymphatic Diseases [C15]
Gender: Female, Male. Age: 18-64 years, 65+ years. Enrolment: 34.
Status: Ongoing, recruiting. Start date (EU): 2024-07-09. Decision date: 2024-04-29. Results received: No. Last updated: 2026-02-04.
Decision dates by country: FR: 2024-04-29, IT: 2024-09-24

Condition(s): Peripheral T cells lymphoma (PTCL)

Primary endpoint: Dose Escalation (Part 1) - Incidence of dose limiting toxicities (DLTs) in the first cycle; a cycle is 28 days in duration., Dose Escalation (Part 1) - Incidence, intensity, and seriousness of treatment emergent adverse events (TEAEs) graded according to the National Cancer Institute (NCI) Common Terminology Criteria for Adverse Events (CTCAE) v5 except for tumor lysis syndrome which will be graded according to widely accepted specialized criteria provided in Appendix XI of the Protocol and cytokine release syndrome based on criteria in Appendix X of the Protocol.., Dose Escalation (Part 1) - Incidence and magnitude of clinically significant changes in clinical laboratory parameters., Dose Escalation (Part 1) - Incidence and severity of clinically significant findings in vital signs, electrocardiogram (ECG), and other physical examination., Dose Expansion (Part 2) - ORR defined as the proportion of participants with CR or PR assessed by Investigators according to Lugano criteria with the LYRIC modification for immunomodulatory drug within 3 months after LIS1 initiation
Endpoint(s): Dose Escalation (Part 1) - LIS1 concentrations in serum and PK parameters including maximum concentration (Cmax), time to maximum concentration (Tmax), area under the curve (AUC) from 0 to 24 hours (AUC24h), AUC0-14 days, AUC15-28 days, AUC0-28 days half-life (T½), clearance (CL), volume of distribution (Vd), and minimum concentration (Cmin), Dose Escalation (Part 1) - Objective response rate (ORR): defined as the proportion of participants with complete response (CR) or partial response (PR) assessed by the Investigators according to Lugano criteria with the LYRIC modification for immunomodulatory drug., Dose Escalation (Part 1) - Duration of response: defined as the time interval between the first confirmed objective response (CR or PR per Lugano criteria) and the first occurrence of objective tumor progression (progressive disease [PD] per Lugano criteria) or death from any cause., Dose Escalation (Part 1) - Time to response (TTR): defined as the time from the date of LIS1 initiation to the date of the first confirmed objective response (CR or PR per Lugano criteria)., Dose Escalation (Part 1) - Progression-free survival (PFS): defined as the time from the date of LIS1 initiation to the date of first documented progression (Lugano criteria) or death., Dose Escalation (Part 1) - Overall survival (OS): defined as the time interval between the date of LIS1 initiation and the date of death due to any cause., Dose Escalation (Part 1) - Number and percentage of participants who develop detectable anti-drug antibodies (ADA)., Dose Expansion (Part 2) - Proportion of each best overall response category (CR, PR, SD, and PD)., Dose Expansion (Part 2) - Duration of response., Dose Expansion (Part 2) - TTR, PFS, and OS., Dose Expansion (Part 2) - Incidence, intensity, and seriousness of TEAEs experienced according to the NCI CTCAE v5., Dose Expansion (Part 2) - Incidence and magnitude of clinically significant changes in clinical laboratory parameters, suggestive of possible trends, but not necessarily establishing clinical abnormality., Dose Expansion (Part 2) - Incidence and severity of clinically significant findings in vital signs, ECG, and other physical examination., Dose Expansion (Part 2) - Frequency of dose interruptions and dose reductions., Dose Expansion (Part 2) - Number and percentage of participants who develop detectable ADA., Dose Expansion (Part 2) - LIS1 concentrations in serum and PK parameters including Cmax, Tmax, AUC24h, AUC0-14 days, AUC15-28 days, AUC0-28 days T½, CL, Vd, and Cmin., Dose Escalation (Part 1) - Proportion of patients “bridged to transplantation”, Dose Expansion (Part 2) - Proportion of patients “bridged to transplantation”

Source: https://euclinicaltrials.eu/ctis-public/view/2023-509648-88-00